EU clinical trial 2024-515895-11-00: Determination Of Molecular Status And Benefit Of Use Fludeoxyglucose (18F-FDG) In PET/CT imagining In Juvenile Patients With Histiocytosis
Protocol code: HISTIOGEN
Sponsor: Instytut Matki I Dziecka (Hospital/Clinic/Other health care facility). Phase: Therapeutic use (Phase IV). Countries: Poland (ongoing, recruiting).
Therapeutic area(s): Analytical, Diagnostic and Therapeutic Techniques and Equipment [E] - Diagnosis [E01]
Gender: Female, Male. Age: 0-17 years. Enrolment: 150.
Status: Ongoing, recruiting. Start date (EU): 2021-04-15. Decision date: 2024-08-26. Results received: No. Last updated: 2025-10-30.

Condition(s): histiocytic cell proliferation
Product: Fludeoxyglucose (18F) Synektik, 200-2200 MBq/ml, roztwór do wstrzykiwań, GLUNEKTIK, 1 GBq/mL, roztwór do wstrzykiwań

Primary endpoint: EFS – (event-free survival).
Endpoint(s): PFS (Progression-Free Survival), OS (Overall Survival), ORR (Overall Response Rate), Reactivation rate after 2 years, Rate of participants presenting with Adverse Events separated by degree of intensity, category, affected organ or system.

Source: https://euclinicaltrials.eu/ctis-public/view/2024-515895-11-00